EU clinical trial 2024-512634-15-00: OASIS II - A randomized phase II trial evaluating Ibrutinib plus CD20 Ab and Ibrutinib-Venetoclax plus CD20 Ab in patients with untreated mantle cell lymphoma
Protocol code: Oasis II
Sponsor: LYSARC (Laboratory/Research/Testing facility). Phase: Phase I and Phase II (Integrated)- Other. Countries: Belgium (ongoing, recruitment ended), France (ongoing, recruitment ended).
Therapeutic area(s): Diseases [C] - Immune System Diseases [C20]; Diseases [C] - Hemic and Lymphatic Diseases [C15]
Gender: Female, Male. Age: 18-64 years, 65+ years. Enrolment: 218.
Status: Ongoing, recruitment ended. Start date (EU): 2022-01-05. Decision date: 2024-05-21. Results received: No. Last updated: 2026-08-03.
Decision dates by country: BE: 2024-05-21, FR: 2024-06-07

Condition(s): Patients with untreated mantle cell lymphoma
Product: RITUXIMAB, VENETOCLAX, RITUXIMAB, IBRUTINIB, OBINUTUZUMAB

Primary endpoint: The primary endpoint is the MRD negativity rate at the end of induction (after 6 cycles) in the informative MRD set using ddPCR technique. We expect to have an increase of 12% of the MRD negativity rate in each arm.
Endpoint(s): PFS at 3 years. We expect to have an increase of 10% of the PFS at 3 years in each arm.

Source: https://euclinicaltrials.eu/ctis-public/view/2024-512634-15-00